EU clinical trial 2024-511119-11-00: A Study of ZW171 in Participants with Advanced or Metastatic Mesothelin Expressing Cancers
Protocol code: ZWI-ZW171-101
Sponsor: Zymeworks Inc. (Pharmaceutical company). Phase: Human Pharmacology (Phase I)- First administration to humans. Countries: Germany (ended).
Therapeutic area(s): Diseases [C] - Neoplasms [C04]
Gender: Female, Male. Age: 18-64 years, 65+ years. Enrolment: 25.
Status: Ended. Start date (EU): 2025-03-07. End date (EU): 2025-10-01. End date: 2025-10-02. Decision date: 2024-10-17. Results received: No. Last updated: 2025-10-06.
Decision dates by country: DE: 2025-01-24

Condition(s): Advanced or metastatic ovarian cancer, NSCLC, pancreatic cancer, and other mesothelin expressing cancers

Source: https://euclinicaltrials.eu/ctis-public/view/2024-511119-11-00